EU clinical trial 2025-521023-75-00: An open-label Phase 2 study to investigate the efficacy and safety of rilzabrutinib in adult participants with Graves’ disease
Protocol code: PDY18663
Sponsor: Sanofi-Aventis Recherche & Developpement (Pharmaceutical company). Phase: Therapeutic exploratory (Phase II). Countries: Spain (ongoing, recruiting), Italy (ongoing, recruiting), Germany (ongoing, recruiting), Greece (authorised, recruitment pending), Hungary (authorised, recruitment pending).
Therapeutic area(s): Diseases [C] - Immune System Diseases [C20]
Gender: Female, Male. Age: 18-64 years, 65+ years. Enrolment: 39.
Start date (EU): 2025-10-03. Decision date: 2025-07-16. Results received: No. Last updated: 2026-07-24.
Decision dates by country: DE: 2025-07-16, ES: 2025-07-16, IT: 2025-07-16, GR: 2026-06-09, HU: 2026-07-21

Condition(s): Immune system diseases
Product: Rilzabrutinib, Rilzabrutinib

Primary endpoint: Percent change from baseline in FT4 levels
Endpoint(s): Percent change from baseline in FT3 levels, Proportion of participants with FT4 levels within normal limits, Proportion of participants with FT3 levels within normal limits, Incidence of treatment-emergent adverse events (TEAEs), serious adverse events (SAEs), adverse events of special interest (AESIs) and withdrawals due to TEAEs during the study period

Source: https://euclinicaltrials.eu/ctis-public/view/2025-521023-75-00